EU clinical trial 2022-503140-41-00: A Phase 3, multicenter, randomized, open-label, parallel group, treatment study to assess the efficacy and safety of the lifileucel (LN-144, autologous tumor-infiltrating lymphocytes [TIL]) regimen in combination with pembrolizumab compared with pembrolizumab monotherapy in participants with untreated, unresectable or metastatic melanoma
Protocol code: IOV-MEL-301
Sponsor: Iovance Biotherapeutics Inc. (Pharmaceutical company). Phase: Therapeutic confirmatory (Phase III). Countries: Germany (ongoing, recruiting), France (authorised, recruiting), Italy (ongoing, recruiting), Netherlands (ongoing, recruiting), Spain (ongoing, recruiting), Belgium (ongoing, recruiting), Sweden (ongoing, recruiting), Czechia (ended), Greece (ended), Finland (authorised, recruiting), Poland (ended), Slovenia (ended).
Therapeutic area(s): Diseases [C] - Skin and Connective Tissue Diseases [C17]
Gender: Female, Male. Age: 18-64 years, 65+ years. Enrolment: 290.
Start date (EU): 2025-12-19. Decision date: 2023-12-13. Results received: No. Last updated: 2026-08-07.
Decision dates by country: PL: 2025-05-26, GR: 2025-05-13, CZ: 2025-05-20, SI: 2025-04-17, NL: 2023-12-13, IT: 2023-12-14, BE: 2023-12-18, ES: 2023-12-14, SE: 2023-12-13, FR: 2023-12-14, DE: 2023-12-15, FI: 2025-06-16

Condition(s): Melanoma
Product: KEYTRUDA 25 mg/mL concentrate for solution for infusion, MESNA, KEYTRUDA 25 mg/mL concentrate for solution for infusion, KEYTRUDA 25 mg/mL concentrate for solution for infusion, KEYTRUDA 25 mg/mL concentrate for solution for infusion, KEYTRUDA 25 mg/mL concentrate for solution for infusion, Proleukin 18 x 106 IE Poeder voor oplossing voor injectie of infusie, Endoxan, Флударабин Актавис 25 mg/ml концентрат за инжекционен или инфузионен разтвор, KEYTRUDA 25 mg/mL concentrate for solution for infusion, Fludarabine phosphate 25 mg/ml Concentrate for Solution for Injection or Infusion, PROLEUKIN® 18 x 106 IU Powder for solution for injection or infusion, KEYTRUDA 25 mg/mL concentrate for solution for infusion, Fludarabine Teva 25 mg/ml concentraat voor oplossing voor injectie of infusie, KEYTRUDA 25 mg/mL concentrate for solution for infusion, FLUDARABINE, Endoxan 1000 mg milteliai injekciniam tirpalui, Lifileucel, Fludarabina Teva 25 mg/ml concentrado para solución para perfusión o inyección EFG, Fludarabine Teva 25 mg/ml solution à diluer pour injection ou perfusion, Cyclophosphamide 1000 mg Powder for Solution for Injection or Infusion, Cyclophosphamide Injection 1 g, Fludarabine - PCH 25 mg/ml, concentraat voor oplossing voor intraveneuze infusie of injectie, MESNA, Fludarabine Accord 25 mg/ml koncentratas injekciniam ar infuziniam tirpalui, Fludarabine Phosphate 25 mg/ml Concentrate for Solution for Injection or Infusion

Primary endpoint: PFS is defined as the time from the date of randomization until disease progression assessed by the BIRC per RECIST v1.1 or death due to any cause
Endpoint(s): OS is defined as the time from the date of randomization to death due to any cause

Source: https://euclinicaltrials.eu/ctis-public/view/2022-503140-41-00